EU clinical trial 2024-513018-36-00: A Phase 3, randomized, double-blind, placebo-controlled, parallel group study to evaluate the efficacy and safety of belimumab administered subcutaneously in adults with interstitial lung disease (ILD) associated with connective tissue disease (CTD).
Protocol code: 221672
Sponsor: Glaxosmithkline Research & Development Limited (Pharmaceutical company). Phase: Therapeutic confirmatory (Phase III). Countries: Belgium (ongoing, recruiting), Netherlands (authorised, recruitment pending), Germany (ongoing, recruiting), France (ongoing, recruiting), Greece (ongoing, recruiting), Spain (ongoing, recruiting), Italy (ongoing, recruiting).
Therapeutic area(s): Diseases [C] - Respiratory Tract Diseases [C08]
Gender: Female, Male. Age: 18-64 years, 65+ years. Enrolment: 126.
Start date (EU): 2025-03-06. Decision date: 2024-10-07. Results received: No. Last updated: 2026-07-17.
Decision dates by country: NL: 2024-10-09, BE: 2024-10-11, IT: 2024-10-09, FR: 2024-10-08, ES: 2024-10-07, GR: 2024-10-08, DE: 2024-11-18

Condition(s): Lung Diseases, Interstitial
Product: Placebo for Belimumab Solution for Injection, 200 mg/mL. The placebo for Belimumab Solution for Injection, 200 mg/mL is provided as a sterile solution for subcutaneous (SC) injection in single-use prefilled syringes., Benlysta 200 mg solution for injection in pre-filled syringe.

Primary endpoint: Absolute change from baseline in FVC (mL) at Week 52.
Endpoint(s): Absolute change from baseline in FVC % predicted at Week 52., Time to ILD progression or death as defined in Section 3.1.1, Absolute change from baseline in FACIT-Fatigue score at Week 52, Absolute change from baseline in L-PF total symptom score at Week 52, Absolute change from baseline in QILD-WL at Week 52 Absolute change from baseline in QLF-WL at Week 52 Absolute change from baseline in QGGO-WL at Week 52, Achieving relative decline from baseline in FVC (mL) ≥5% at Week 52. • Achieving relative decline from baseline in FVC (mL) ≥10% at Week 52., Absolute change from baseline in steroid dose (prednisone equivalent dose) at Week 52, Time to CTD progression as defined in Section 3.1.2, Absolute change from baseline in TDI at Week 52. Absolute change from baseline in SF36-v2 at Week 52 Absolute change from baseline in Living with Pulmonary Fibrosis (L-PF) Impacts total score at Week 52 Absolute change from baseline in King's Brief Interstitial Lung Disease Questionnaire (K-BILD) at Week 52 Absolute change from baseline in PhGA at Week 52. Absolute change in Patient PGIC-ILD at week 52, Absolute change from baseline in DLco % predicted at Week 52., Incidence of AEs, AESIs and SAEs up to Week 52. Incidence of respiratory related hospitalisations up to Week 52.

Source: https://euclinicaltrials.eu/ctis-public/view/2024-513018-36-00